EU clinical trial 2025-524111-37-00: Phase 1/2A Study of OTP-01, a Dual Paratopic PD-1/VEGFR2 Antibody, in Patients with Advanced Solid Tumors
Sponsor: Ottimo Pharma Limited (Pharmaceutical company). Phase: Phase I and Phase II (Integrated)- First administration to humans. Countries: Ireland (ongoing, recruiting), Spain (ongoing, recruiting), Portugal (ongoing, recruiting).
Therapeutic area(s): Diseases [C] - Neoplasms [C04]
Gender: Female, Male. Age: 18-64 years, 65+ years. Enrolment: 41.
Status: Ongoing, recruiting. Start date (EU): 2026-04-28. Decision date: 2026-04-14. Results received: No. Last updated: 2026-05-11.
Decision dates by country: IE: 2026-04-22, ES: 2026-04-20, PT: 2026-05-11

Condition(s): advanced solid tumors

Primary endpoint: Phase 1 - Inclusive of all aspects of safety, tolerability, biologic activity, PK, pharmacodynamics (PD) and preliminary efficacy, Phase 1 - Frequency and severity of adverse events (AEs) and serious adverse events (SAEs), Phase 2A - Objective Response Rate (ORR), Phase 2A - Duration of response (DOR), Phase 2A - Disease control rate (DCR), Phase 2A - Progression free survival (PFS), Phase 2A - Frequency and severity of AEs and SAEs
Endpoint(s): Phase 1 - Objective Response Rate (ORR), Phase 1 - Duration of response (DOR), Phase 1 - Disease control rate (DCR), Phase 1 - Progression free survival (PFS), Phase 1 and 2A- Plasma concentrations of OTP-01 as a function of time post-dosing, Phase 1 and 2A- PK parameters (area under the curve [AUC], maximum plasma concentration [Cmax], minimum plasma concentration [Cmin], time of maximum concentration [Tmax], half-life [t1/2], clearance [CL]) for single (first) dose and multiple doses

Source: https://euclinicaltrials.eu/ctis-public/view/2025-524111-37-00